EU clinical trial 2022-501534-33-00: Luteal Phase Support in MOH-IUI treatment (LUMO study)
Protocol code: V0001227
Sponsor: University Medical Center Utrecht (Hospital/Clinic/Other health care facility). Phase: Therapeutic use (Phase IV). Countries: Netherlands (ongoing, recruitment ended).
Therapeutic area(s): Diseases [C] - Female Urogenital Diseases and Pregnancy Complications [C13]; Phenomena and Processes [G] - Reproductive and Urinary Physiological Phenomena [G08]
Gender: Female. Age: 18-64 years. Enrolment: 1008.
Status: Ongoing, recruitment ended. Start date (EU): 2023-03-06. Decision date: 2023-01-31. Results received: No. Last updated: 2025-03-31.

Condition(s): Unexplained Subfertility, infertility
Product: Utrogestan 300 mjuk vaginalkapsel, The used Placebo in this trial is Placebo 300mg soft capsule, in order to match the corresponding active product. The placebo, soft capsule, is an oblong, slightly yellow capsule containing a whitish oily solution. The placebo presentation is modelled on the corresponding active presentation for the purposes of blinding the IMPs. The manufacture and control of the placebo is essentially the same as for the active, but without progesterone drug substance and with appropriately compensating quantities of some excipients. Manufacturing site of the placebo is the same as the actives (Cyndea)

Primary endpoint: Pregnancy occurring within 6 months after randomization, leading to Live birth
Endpoint(s): Clinical pregnancy, ongoing pregnancy, biochemical pregnancy loss and miscarriage rates within 6 months after randomisation., For each participant, number of MOH-IUI cycles initiated, completed and cancelled are evaluated within 6 months after randomisation., Of all achieved (ongoing) pregnancies occurring within 6 months after randomization (including spontaneous pregnancies) the following outcomes are assessed; multiple pregnancy rate, time to pregnancy, pregnancy complications, perinatal outcomes, type of delivery and outcomes, Side effects and compliance to therapy assessed during treatment using a medication dairy and a questionnaire, send out 6 months after randomization., Quality of life assessed at time of randomization, and 6 and 18 months after randomization, using the FertiQoL questionnaire, Progression to IVF/ICSI within six months after randomization, Use of ART and (ongoing) pregnancy achieved after the six-month study period and within 12 months follow up., Budget impact, Cost-effectiveness analyses using live birth rates, costs and quality of life.

Source: https://euclinicaltrials.eu/ctis-public/view/2022-501534-33-00